EU clinical trial 2024-513548-27-00: A multicenter, international, open-label, safety study of ND0612, a solution of levodopa/carbidopa delivered via a pump system as a continuous subcutaneous infusion in subjects with advanced Parkinson's Disease (BeyoND)
Protocol code: ND0612H-012
Sponsor: Neuroderm Ltd. (Pharmaceutical company). Phase: Therapeutic exploratory (Phase II). Countries: Italy (ended), Austria (ended), France (ended), Poland (ongoing, recruitment ended).
Therapeutic area(s): Diseases [C] - Nervous System Diseases [C10]
Gender: Female, Male. Age: 18-64 years, 65+ years. Enrolment: 42.
Start date (EU): 2016-10-05. Decision date: 2024-06-24. Results received: No. Last updated: 2026-06-29.
Decision dates by country: AT: 2024-06-24, IT: 2024-07-03, PL: 2024-06-24, FR: 2024-06-24

Condition(s): Parkinson's disease
Product: ND0612

Primary endpoint: Safety endpoint assessing the long-term safety (systemic and local) and tolerability of continuous SC infusion of ND0612 throughout the 12-month treatment period.
Endpoint(s): Assessment of suicidal behavior and ideation., Assessment of impulsive compulsive behavior, Epworth Sleepiness Scale, Vital signs with a focus on orthostatic BP, Laboratory data (hematology and biochemistry), including dipstick urinalysis results evaluation, 12-lead ECG parameters, including ECG interpretation of clinical significance, Physical examination, Prior and concomitant medications, Change in daily “ON” time without troublesome dyskinesia, Change in daily “OFF” time from Baseline to the 12-month visit, based on home “ON/OFF” diaries, Change in total daily dose of oral LD/DDI from baseline to the 12 month visit, Proportion of responders at the 12-month visit based on daily “OFF” time recorded in home “ON/OFF” diaries., Change in daily “ON” time with troublesome dyskinesia in a subset of subjects who had more than 1 hour of troublesome dyskinesia at Baseline, based on home “ON/OFF” diaries from Baseline to the 12- month visit., Change in PDQ-39 scores from Baseline to the 12 month visit, Change in EQ-5D-5L scores from Baseline to the 12 month visit, Change in UPDRS Part II (ADL) from Baseline to the 12 month visit, Change in CGI-Severity and CGI-Improvement from Baseline to the 12 month visit, Change in SGI-Improvement from Baseline to the 12 month visit, Change in PDSS total score from Baseline to the 12 month visit, Change in UPDRS Part III (motor score) from Baseline to the 12 month visit, Change from baseline to month 12 in percentage of “OFF” time and percentage of ‘Good’ ON during the first 3 hours since the subject is awake after 06:00 (6 am), Change from baseline to month 12 in ND0612 total dose, Proportion of patients who reduced ND0612 total dose at any time during the study

Source: https://euclinicaltrials.eu/ctis-public/view/2024-513548-27-00